EU clinical trial 2023-503565-36-00: PREOPERATIVE WINDOW OF OPPORTUNITY STUDY WITH GIREDESTRANT (GDC-9545) OR TAMOXIFEN IN PREMENOPAUSAL WOMEN WITH ER[+]/HER2[-] & KI67≥10% EARLY BREAST CANCER
Protocol code: MedOPP459 "EMPRESS"
Sponsor: Medica Scientia Innovation Research S.L. (Pharmaceutical company). Phase: Therapeutic exploratory (Phase II). Countries: Spain (ended), France (ended).
Therapeutic area(s): Diseases [C] - Neoplasms [C04]
Gender: Female. Age: 18-64 years, 65+ years. Enrolment: 92.
Status: Ended. Start date (EU): 2023-07-19. End date (EU): 2025-01-30. Decision date: 2023-05-29. Results received: Yes. Last updated: 2024-08-07.
Decision dates by country: ES: 2023-05-29, FR: 2023-06-09

Condition(s): ER[+]/HER2[-] & Ki67≥10% early breast cancer (EBC)
Product: RO7197597, TAMOXIFEN

Primary endpoint: Changes in tumor cell proliferation as measured by Ki67 expression between baseline and post-treatment tumor biopsy samples by central assessment in patients with centrally confirmed Ki67 ≥10% (Arm A vs Arm B).
Endpoint(s): CCCA in all arms, defined as the percentage of participants with centrally assessed Ki67 scores ≤2.7% stained nuclei upon treatment (post-treatment sample)., Changes in markers (such as ER and PgR levels) and molecular profiling using HTG (PAM-like molecular test)., Incidence and severity of adverse events (AEs), with severity determined in accordance with NCI-CTCAE v.5.0., Plasma endocrine panel performed pre- and post-therapy., Expression of ER and PgR in samples pre- and post-therapy., Other exploratory studies to be determined.

Source: https://euclinicaltrials.eu/ctis-public/view/2023-503565-36-00